EU clinical trial 2023-508995-12-01: LuMIERE: A Phase 1/2, Multicenter, Open label, Non randomized Study to Investigate Safety and Tolerability, Pharmacokinetics, Dosimetry, and Preliminary Activity of [177Lu]Lu FAP 2286 in Participants with an Advanced Solid Tumor
Protocol code: CAAA614A12101
Sponsor: Novartis Pharma AG (Pharmaceutical company). Phase: Therapeutic exploratory (Phase II). Countries: Italy (authorised, recruitment pending), Spain (ongoing, recruiting), Belgium (authorised, recruitment pending), France (ongoing, recruiting).
Therapeutic area(s): Diseases [C] - Neoplasms [C04]
Gender: Female, Male. Age: 18-64 years, 65+ years. Enrolment: 36.
Start date (EU): 2025-12-24. Decision date: 2025-08-26. Results received: No. Last updated: 2026-02-16.
Decision dates by country: BE: 2025-08-28, ES: 2025-08-26, FR: 2025-08-27, IT: 2025-08-26

Condition(s): Recurrent or metastatic non-small cell lung cancer (NSCLC), Locally advanced unresectable or metastatic pancreatic ductal adenocarcinoma (PDAC), Metastatic Breast Carcinoma (BC)
Product: Abraxane, CAAA614A12101, PACLITAXEL ALBUMIN-BOUND, OXALIPLATIN, FLUOROURACIL, AAA614, IRINOTECAN, AAA514, CALCIUM FOLINATE

Primary endpoint: Investigator-assessed ORR per RECIST v1.1, Dose-limiting toxicities (DLTs), adverse events (AEs), serious AEs (SAEs) and clinical laboratory abnormalities
Endpoint(s): DOR per RECIST v1.1, as assessed by investigator, Confirmed partial response (PR) or complete response (CR), or stable disease (SD) of at least 12 weeks, Disease progression according to RECIST v1.1, as assessed by investigator, or death due to any cause, AEs, SAEs, and clinical laboratory abnormalities at the RP2D of [177Lu]Lu-FAP-2286 for monotherapy, the RP2D in combination with mFOLFIRINOX in PDAC and the RP2D in combination with nab-paclitaxel in NSCLC (Phase 2 dose expansion), AEs and SAEs during and after [68Ga]Ga-FAP-2286 administration

Source: https://euclinicaltrials.eu/ctis-public/view/2023-508995-12-01